EU clinical trial 2024-511794-30-00: Combination treatment of Belantamab Mafodotin and Venetoclax in treatment of relapsed and refractory t(11;14) Multiple Myeloma (Phase I/IIa) _ The BELI(E)VE-Trial
Protocol code: The BELI(E)VE-Trial
Sponsor: University Medical Center Hamburg-Eppendorf (Hospital/Clinic/Other health care facility). Phase: Phase I and Phase II (Integrated)- Other. Countries: Germany (ongoing, recruiting).
Therapeutic area(s): Diseases [C] - Hemic and Lymphatic Diseases [C15]
Gender: Female, Male. Age: 18-64 years, 65+ years. Enrolment: 43.
Status: Ongoing, recruiting. Start date (EU): 2023-06-28. Decision date: 2024-10-18. Results received: No. Last updated: 2026-03-27.

Condition(s): Multiple Myeloma

Source: https://euclinicaltrials.eu/ctis-public/view/2024-511794-30-00